EU clinical trial 2025-523675-39-00: A Phase 3, Randomized, Double-Blind, Placebo-Controlled, 3-Arm Study to Investigate the Safety and Efficacy of Efimosfermin Alfa in Participants With Biopsy-Confirmed F2- or F3-Stage Metabolic Dysfunction-Associated Steatohepatitis (MASH) (ZENITH-1)
Protocol code: 301160
Sponsor: Glaxosmithkline Research & Development Limited (Pharmaceutical company). Phase: Therapeutic confirmatory (Phase III). Countries: Belgium (authorised, recruiting), Greece (authorised, recruitment pending), Poland (ongoing, recruiting), France (authorised, recruitment pending), Spain (authorised, recruitment pending), Bulgaria (authorised, recruiting), Italy (authorised, recruitment pending), Germany (authorised, recruiting), Austria (authorised, recruitment pending), Netherlands (authorised, recruitment pending).
Therapeutic area(s): Diseases [C] - Nutritional and Metabolic Diseases [C18]
Gender: Female, Male. Age: 18-64 years, 65+ years. Enrolment: 173.
Start date (EU): 2026-07-22. Decision date: 2026-06-08. Results received: No. Last updated: 2026-08-07.
Decision dates by country: AT: 2026-06-14, BE: 2026-06-08, BG: 2026-06-16, DE: 2026-06-16, IT: 2026-06-17, NL: 2026-06-15, PL: 2026-06-18, GR: 2026-06-09, FR: 2026-06-22, ES: 2026-06-15

Condition(s): Metabolic Dysfunction-Associated Steatohepatitis (MASH)
Product: Placebo for Efimosfermin alfa.

Primary endpoint: Proportion of participants experiencing improvement in fibrosis by >=1 stage and no worsening of steatohepatitis at Week 52., Proportion of participants experiencing resolution of steatohepatitis reading and no worsening of MASH CRN fibrosis score at Week 52., Time from randomization to an adjudicated composite liver-related clinical outcome.
Endpoint(s): For all participants at Week 52 and at Month 48 Number of participants with treatment-emergent adverse events (TEAEs) and TEAEs by severity Number of participants with TEAEs leading to discontinuation and TEAEs leading to discontinuation by severity Number of participants with Grade 3 and Grade 4 laboratory abnormalities., Proportion of participants with: resolution of steatohepatitis on histopathological reading and improvement in liver fibrosis >=1 stage at Week 52 improvement in fibrosis >=1 stage and no worsening of Steatohepatitis at Month 48 improvement in fibrosis >=2 stage and no worsening of Steatohepatitis at Week 52 and Month 48 resolution of steatohepatitis and no worsening of MASH CRN score at Month 48, Absolute and relative change from baseline to Week 52 and Month 48 in VCTE-LSM and CAP scores for all participants. Achieving a change from baseline in VCTE-LSM ≥ 30% at Week 52 and Month 48., Absolute and relative change from baseline to Week 52 and Month 48 in the subset of participants with MRE scores., Absolute and relative change from baseline to Week 52 and Month 48 in ELF score for all participants. Achieving improvement in ELF score of ≥ 0.5., Absolute and relative change from baseline to Week 52 and Month 48 in HFF by MRI-PDFF for all participants. Absolute and relative change from baseline to Week 52 and Month 48 in ALT, AST, and ALT/AST ratio for all participants. Achieving ALT and HFF normalization at Week 52 and Month 48. Achieving HFF ≤ 5%., Change from baseline to Week 52 and Month 48 in HbA1c for participants with T2DM. Change from baseline to Week 52 and Month 48 in body weight for all participants., Change from baseline in fasting total cholesterol, LDL-C, HDL-C, and fasting triglycerides at Week 52 and Month 48 for all participants., Proportion of participants with antidrug and antiFGF21 antibody (ADA)., Change from baseline in CLDQ-NASH domain and total scores at Week 52 and Month 48. Change from baseline in SF-36 component and domain scores at Week 52 and Month 48., Serum drug Concentration of efimosfermin alfa.

Source: https://euclinicaltrials.eu/ctis-public/view/2025-523675-39-00